EU clinical trial 2026-526225-18-00: A phase I/IIa safety, dose finding and feasibility trial of CD30/CEA CART in patients with liver metastases from CEA positive colorectal adenocarcinoma
Protocol code: CD30/CEA CART_001
Sponsor: Universitaetsklinikum Regensburg AöR (Hospital/Clinic/Other health care facility). Phase: Phase I and Phase II (Integrated)- First administration to humans. Countries: Germany (authorised, recruitment pending).
Therapeutic area(s): Diseases [C] - Neoplasms [C04]
Gender: Female, Male. Age: 18-64 years, 65+ years. Enrolment: 18.
Status: Authorised, recruitment pending. Decision date: 2026-07-20. Results received: No. Last updated: 2026-07-20.

Condition(s): Colorectal Adenocarcinoma
Product: CD30/CEA CART

Primary endpoint: Incidence and severity of adverse events (AEs) and adverse events of special interest (AESIs) grouped by MedDRA system organ class and preferred terms and according to CTCAE version 6.0*, Occurrence of dose-limiting toxicities (DLTs) during the DLT evaluation period, Percent (%) of subjects who received the planned dose of CD30/CEA CART
Endpoint(s): Key secondary efficacy endpoint: Objective response rate (ORR) defined as the proportion of patients in whom a CR or PR per RECIST v1.1 is observed as best overall response, Disease control rate (DCR) defined as the proportion of patients in whom CR, PR, or stable disease (SD; lasting 6 or more weeks) is observed as best overall response, Duration of response (DoR) defined as the time from the first objective response (CR or PR per RECIST v1.1) to first occurrence of objective progressive disease (PD) per RECIST v1.1/recurrence or death from any cause, whichever occurs first, Progression-free survival (PFS) based on RECIST v1.1, Time to progression (TTP), Overall survival (OS), Quantification of CD30/CEA CART in peripheral blood

Source: https://euclinicaltrials.eu/ctis-public/view/2026-526225-18-00